EU clinical trial 2024-513638-39-00: A clinical study to determine the dose and assess safety and efficacy of radioimmuntherapy in patients with glioblastoma, where Lutetium 177 labelled 6A10 antibody Fab fragments are applied to the tumor resection cavity.
Protocol code: UKM15_0027
Sponsor: Universitaetsklinikum Muenster AöR (Hospital/Clinic/Other health care facility). Phase: Human Pharmacology (Phase I)- First administration to humans. Countries: Germany (ongoing, recruitment ended).
Therapeutic area(s): Diseases [C] - Neoplasms [C04]
Gender: Female, Male. Age: 18-64 years, 65+ years. Enrolment: 15.
Status: Ongoing, recruitment ended. Start date (EU): 2022-10-17. Decision date: 2024-07-10. Results received: No. Last updated: 2026-07-30.

Condition(s): Surgically treated high grade glioma after concomitant radiochemotherapy and adjuvant standard chemotherapy, with no or small stable tumor residue

Source: https://euclinicaltrials.eu/ctis-public/view/2024-513638-39-00